EU clinical trial 2022-502154-13-00: Efficacy, safety and patient-reported outcomes of peptide receptor radionuclide therapy with 177Lu-edotreotide compared to everolimus in somatostatin receptor positive neuroendocrine tumors of the lung and thymus. The LEVEL trial
Protocol code: GETNE-T2217
Sponsor: Grupo Espanol De Tumores Neuroendocrinos (Patient organisation/association). Phase: Therapeutic confirmatory (Phase III). Countries: Spain (ongoing, recruiting), France (ongoing, recruiting), Italy (ongoing, recruiting), Belgium (ongoing, recruiting).
Therapeutic area(s): Diseases [C] - Neoplasms [C04]
Gender: Female, Male. Age: 18-64 years, 65+ years. Enrolment: 170.
Status: Ongoing, recruiting. Start date (EU): 2023-10-27. Decision date: 2023-07-14. Results received: No. Last updated: 2026-02-12.
Decision dates by country: IT: 2023-11-08, FR: 2023-10-10, ES: 2023-07-14, BE: 2024-10-23

Condition(s): Patients with well to moderately differentiated neuroendocrine tumors of the lung and thymus who require systemic therapy.
Product: 177Lu-Edotreotide, Afinitor 10 mg tablets, Arginine-Lysine solution for infusion

Primary endpoint: The primary endpoint for the LEVEL Trial is the progression-free survival (PFS) defined as the time from the date of randomization to the date of first documentation of disease progression according to RECIST 1.1 by investigator-assessment or death due to any cause, whichever occurs first

Source: https://euclinicaltrials.eu/ctis-public/view/2022-502154-13-00